EU clinical trial 2023-503830-27-00: A Randomized, Open-Label, Phase 2 Study Evaluating Lymphodepletion With Fludarabine, Cyclophosphamide, And ALLO-647, Vs. Fludarabine And Cyclophosphamide Alone, In Subjects With Relapsed/Refractory Large B-Cell Lymphoma (LBCL) Receiving ALLO-501A Allogeneic CAR T Cell Therapy
Protocol code: ALLO-647-201
Sponsor: Allogene Therapeutics Inc. (Pharmaceutical company). Phase: Therapeutic exploratory (Phase II). Countries: Belgium (ended), Germany (ended), Austria (ended).
Therapeutic area(s): Diseases [C] - Immune System Diseases [C20]; Diseases [C] - Neoplasms [C04]; Diseases [C] - Hemic and Lymphatic Diseases [C15]
Gender: Female, Male. Age: 18-64 years, 65+ years. Enrolment: 35.
Status: Ended. Start date (EU): 2023-10-17. End date (EU): 2024-10-28. End date: 2024-10-29. Decision date: 2023-08-23. Results received: Yes. Last updated: 2024-01-29.
Decision dates by country: DE: 2023-08-28, BE: 2023-08-23, AT: 2023-08-28

Condition(s): Large B-Cell Lymphoma (LBCL)
Product: Paracetamol 10 mg/ml solution for infusion, Fludarabine phosphate 25 mg/ml Concentrate for Solution for Injection or Infusion, Cyclophosphamide 500 mg Powder for Solution for Injection or Infusion, PREVYMIS 480 mg film-coated tablets, Solu-Cortef Powder for Solution for Injection or Infusion 100 mg, Phenergan 25mg/ml Solution for Injection, Quamatel 20 mg por és oldószer oldatos injekcióhoz, ALLO-647, PREVYMIS 240 mg film-coated tablets, Fludarabin HEXAL® 25 mg/ml Konzentrat zur Herstellung einer Injektions- oder Infusionslösung, ALLO-501A, RoActemra 20 mg/mL concentrate for solution for infusion, Loratadine 10 mg Tablets

Primary endpoint: Efficacy - PFS in FCA vs FC alone, defined as the time from randomization to disease progression, or relapse per the Lugano classification criteria (Cheson et al, 2014) as assessed by IRC or death
Endpoint(s): Efficacy - ORR in FCA vs FC alone, defined as assessment of CR or PR, assessed using the Lugano classification criteria 2014; Cheson , et al, 2014) by IRC at any time up through commencement of new anti-cancer therapy or withdrawal of consent., Efficacy - EFS in FCA vs FC alone, defined as the time from randomization to disease progression or relapse per the Lugano classification criteria 2014 as assessed by IRC and per investigator assessment, new anticancer therapy, or death, Efficacy - DOR, defined as time from the first observed response to disease progression or relapse (per IRC and per investigator assessment) or death, Efficacy - ORR in FCA vs FC alone per investigator assessment at any time up through commencement of new anti-cancer therapy or withdrawal of consent, Efficacy - Best overall response (CR, PR, SD, PD) (per IRC and per investigator assessment) at any time up through commencement of new anti-cancer therapy or withdrawal of consent, Efficacy - PFS in FCA vs FC alone, defined as time from the randomization to progression or relapse per investigator assessment per the Lugano classification criteria as assessed by investigator, or death, Efficacy - TTR, defined as the time from randomization to the first observed response (per IRC and per investigator assessment), Efficacy - OS in FCA vs FC alone, defined as the time from randomization to death, Efficacy - Depth and duration of lymphodepletion, as assessed by lymphocyte count, PK concentrations will be used in a population PK model, ALLO-501A expansion and persistence, eg, Cmax and AUC., Pharmacodynamics will be evaluated on host T cell counts, The incidence of ADA against ALLO-501A scFv and/or TALEN®, The incidence of ADA against ALLO-647, Safety - AEs as characterized by preferred term, frequency, severity, timing, seriousness, and relationship to ALLO-647, and by FCA vs FC, Safety - The incidence of infusion-related reactions, cytopenias, and infections, Safety - AEs as characterized by preferred term, frequency, severity timing, seriousness, and relationship to ALLO-501A and by FCA vs FC, Safety - The incidence and severity of CRS, neurotoxicity, infections, hematologic toxicities, prolonged cytopenias, and GVHD, Safety - The incidence and severity of clinically significant laboratory toxicities.

Source: https://euclinicaltrials.eu/ctis-public/view/2023-503830-27-00